EU clinical trial 2024-514093-41-00: An Interventional, Phase II, Non Randomized, Mono-centric Study on the Clinical Efficacy and Safety of the Medical Device PAGETEX® as a Photodynamic Therapy Device in the Treatment of Extra-Mammary Paget's Disease of the Vulva (EMPV)
Protocol code: 2017_71
Sponsor: Centre Hospitalier Universitaire De Lille (Hospital/Clinic/Other health care facility). Phase: Therapeutic exploratory (Phase II). Countries: France (authorised, recruiting).
Therapeutic area(s): Diseases [C] - Neoplasms [C04]
Gender: Female. Age: 18-64 years, 65+ years. Enrolment: 24.
Status: Authorised, recruiting. Start date (EU): 2019-08-27. Decision date: 2024-09-20. Results received: No. Last updated: 2025-08-06.

Condition(s): Vulvar Extra Mammary Paget's Disease confirmed by biopsy
Product: METVIXIA 168 mg/g, crème

Primary endpoint: disease control rate defined by the proportion of patients having a clinical response (stability, partial response or complete response to treatment compared to patients who are in progressive disease (increase in size of the lesion, progression to invasive disease and/or adenocarcinoma). The clinical response will be obtained by the investigating doctor during the 3-month visit using the photograph of the lesion at inclusion as a reference.
Endpoint(s): The disease control rate at 6 months, assessed by the investigating doctor, The disease control rate at 3 and 6 months evaluated by an independent committee of doctors (same definition and grading as by the investigating doctor) based on standardized photographs taken during the inclusion visits, at 3 months and at 6 months, The level of quality of life, quality of sexual life, anxiety and depression of the patient assessed from the analysis of the scores of questionnaires validated for dermatology: DLQI, HADS scale, FSFI, SF36 completed at the inclusion visit, at 3 months and at 6 months, The level of pain felt by the patient during each PDT session assessed using a visual analog scale (VAS) graded from 0 (no pain) to 10 (unbearable pain). The level of pain will be classified into 4 levels: 0 = no pain/reaction 1 to 3 = pain/weak reaction 4 to 6 = moderate pain/reaction 7 to 10 = severe pain/reaction, The presence of Paget cells in the thickness of the epidermis after staining of biopsies using the hematoxylin and eosin staining technique (H&E staining). A vulvar biopsy will be performed for each suspicious lesion, whether or not it is symptomatic at the 3-month and 6-month visit, The severity of the erythema at the inclusion visit, at 3 months and at 6 months noted by: The investigating doctor on the basis of a 4-point scale: 0 = no erythema, 1 = mild erythema or pruritus, 2 = moderate erythema (macules, papules, dry desquamation), 3 = severe erythema (vesicles, ulceration, desquamation oozing, necrotic) A quantitative measurement, carried out by colorimetry of an area of damaged skin/or mucosa, defined at inclusion, which will be carried out on 10 to 20 distinct, The presence of PpIX in cancer cells after each PDT session effectively using the Fotofinder® dermoscope. The presence or absence of fluorescence on the images will confirm the presence or absence of residual PpIX and therefore the complete or partial destruction of Paget's cells after the PDT session, The patient's overall level of satisfaction measured at 6 months of PDT treatment (final visit) by the overall score of a self-questionnaire collecting the patient's impressions in terms of practicality of use, comfort, size, duration of treatment and improvement to be made to the device., Collection of all adverse events (AEs and SAEs) from the start of PDT treatment until the last study visit (according to the drift criteria of the National Cancer Institute (NCI-CTCAE version 4.0) after each PDT session and at each follow-up visit (3 months and 6 months => see paragraph 11.3 for details).

Source: https://euclinicaltrials.eu/ctis-public/view/2024-514093-41-00